EU clinical trial 2024-517639-35-00: CHEMOKINE RECEPTOR CXCR4-DIRECTED THERANOSTICS OF ADVANCED LYMPHOPROLIFERATIVE CANCERS BY RADIOPEPTIDE-BASED IMAGING AND THERAPY: THE COLPRIT PHASE I/II STUDY
Protocol code: COLPRIT-0000-BAS-004
Sponsor: Klinikum rechts der Isar der TU Muenchen AöR (Hospital/Clinic/Other health care facility). Phase: Phase I and Phase II (Integrated)- Other. Countries: Germany (authorised, recruitment pending).
Therapeutic area(s): Diseases [C] - Neoplasms [C04]
Gender: Female, Male. Age: 18-64 years, 65+ years. Enrolment: 38.
Status: Authorised, recruitment pending. Decision date: 2024-10-14. Results received: No. Last updated: 2024-10-14.

Condition(s): Non-Hodgkin lymphomas (NHL)
Product: [68Ga]Ga-PentixaFor, [90Y]Y-PentixaTher

Primary endpoint: Phase I: Determination of maximum tolerated dose (MTD), Phase II: ORR
Endpoint(s): Phase I: The dosimetric analysis for the assessment of the radiation dose received by the patient., Phase II: Median PFS, OS, hematopoietic recovery (measured with the time course of CBCs), Safety Endpoints: Frequency and severity of adverse events

Source: https://euclinicaltrials.eu/ctis-public/view/2024-517639-35-00